EU clinical trial 2024-514790-22-00: Transversus Abdominis Plane (TAP) Block vs. Laparoscopic Port Site Wound Infiltration in Patients with Colorectal Cancer Undergoing Scheduled Laparoscopic Surgery Included in the Enhanced Recovery After Surgery (ERAS) Program
Protocol code: TAPIL
Sponsor: Fundacion Para El Fomento De La Investigacion Sanitaria Y Biomedica De La Comunitat Valenciana (Patient organisation/association). Phase: Therapeutic use (Phase IV). Countries: Spain (authorised, recruitment pending).
Therapeutic area(s): Analytical,Diagnostic,Therapeutic Techniques and Equipment [E]-Surgical Procedures, Operative [E04]
Gender: Female, Male. Age: 18-64 years, 65+ years. Enrolment: 174.
Status: Authorised, recruitment pending. Decision date: 2024-09-03. Results received: No. Last updated: 2024-09-03.

Condition(s): Colorectal cancer
Product: LEVOBUPIVACAINE

Primary endpoint: Pain intensity measured with the visual analog scale (VAS),
Endpoint(s): Consumption of minor and major opioids during admission: The milligrams of minor (tramadol) and major (morphine) opioids administered to the patient will be recorded. Data collection times will be the same as for the VAS, at 2, 6, 24, and 48 hours after surgery completio, Incidence of postoperative nausea and vomiting

Source: https://euclinicaltrials.eu/ctis-public/view/2024-514790-22-00